EU clinical trial 2022-501110-56-00: A Phase 1, open-label, non-comparative, multicenter clinical study to evaluate the safety, tolerability, and pharmacokinetics of ceftolozane/tazobactam (MK-7625A) in pediatric participants with nosocomial pneumonia
Protocol code: MK-7625A-036
Sponsor: Merck Sharp & Dohme LLC (Pharmaceutical company). Phase: Human Pharmacology (Phase I)- Other. Countries: Greece (ended), Spain (ended), Estonia (ended).
Therapeutic area(s): Diseases [C] - Bacterial Infections and Mycoses [C01]
Gender: Female, Male. Age: 0-17 years. Enrolment: 14.
Status: Ended. Start date (EU): 2020-02-26. End date (EU): 2024-05-30. End date: 2024-09-26. Decision date: 2023-04-03. Results received: Yes. Last updated: 2024-08-28.
Decision dates by country: GR: 2023-04-03, EE: 2023-04-03, ES: 2023-04-10

Condition(s): Nosocomial infection, Pneumonia
Product: Zerbaxa 1 g/0.5 g powder for concentrate for solution for infusion

Primary endpoint: Percentage of participants with any adverse events (AEs), Percentage of participants with any serious AEs (SAEs), Percentage of participants with any drug-related AEs, Percentage of participants with any drug-related SAEs, Percentage of participants with AEs leading to discontinuation of study intervention
Endpoint(s): Plasma concentrations of ceftolozane, Plasma concentrations of tazobactam, Steady state plasma area under the concentration-time curve of an 8-hour dosing interval (AUC0-8) of plasma ceftolozane, Steady state plasma area under the concentration-time curve of an 8-hour dosing interval (AUC0-8) of plasma tazobactam, Maximum observed concentration during a dosage interval (Cmax) of plasma ceftolozane, Maximum observed concentration during a dosage interval (Cmax) of plasma tazobactam, Elimination half-life (t1/2) of plasma ceftolozane, Elimination half-life (t1/2) of plasma tazobactam, Volume of distribution (Vd) of plasma ceftolozane, Volume of distribution (Vd) of plasma tazobactam, Clearance (CL) of plasma ceftolozane, Clearance (CL) of plasma tazobactam

Source: https://euclinicaltrials.eu/ctis-public/view/2022-501110-56-00